EU clinical trial 2023-509463-24-01: A randomized phase II study of second line treatment with liposomal irinotecan and S1 versus liposomal irinotecan and 5-fluorouracil in patients with metastatic pancreatic cancer who failed on first line gemcitabine-based chemotherapy
Sponsor: Amsterdam UMC (Hospital/Clinic/Other health care facility). Phase: Therapeutic exploratory (Phase II). Countries: Spain (ongoing, recruitment ended), Italy (ended), Netherlands (ongoing, recruitment ended), Austria (ended).
Therapeutic area(s): Diseases [C] - Neoplasms [C04]
Gender: Female, Male. Age: 18-64 years, 65+ years. Enrolment: 146.
Start date (EU): 2019-11-04. Decision date: 2024-12-12. Results received: No. Last updated: 2025-01-09.
Decision dates by country: IT: 2025-01-09, NL: 2024-12-12, ES: 2024-12-17, AT: 2024-12-27

Condition(s): metastatic pancreatic cancer
Product: Onivyde pegylated liposomal 4.3 mg/ml concentrate for dispersion for infusion, Fluorouracil 50mg/ml Injection., Teysuno 15 mg/4.35 mg/11.8 mg hard capsules

Primary endpoint: Progression free survival
Endpoint(s): Overall survival, Response rate according to RECIST 1.1, Adverse events according to NCI CTC version 4.0, Quality of life (QLQ-C30)

Source: https://euclinicaltrials.eu/ctis-public/view/2023-509463-24-01